EU clinical trial 2024-513484-89-00: Open-label Extension Study to Evaluate the Long-term Safety and Efficacy of Mexiletine in Paediatric Patients with Myotonic Disorders Who Have Completed MEX-NM-301.
Protocol code: MEX-NM-303
Sponsor: Lupin Europe GmbH (Pharmaceutical company). Phase: Therapeutic use (Phase IV). Countries: France (ended).
Therapeutic area(s): Diseases [C] - Musculoskeletal Diseases [C05]
Gender: Female, Male. Age: 0-17 years. Enrolment: 12.
Status: Ended. Start date (EU): 2024-11-19. End date (EU): 2026-06-04. Decision date: 2024-11-19. Results received: No. Last updated: 2026-05-02.

Condition(s): Myotonic disorders: Nondystrophic myotonias (NDM) or myotonic dystrophies (DM, type 1 or type 2)
Product: Namuscla 167 mg hard capsules, Mexiletine 62 mg hard capsules, Mexiletine 83 mg hard capsules

Primary endpoint: Number and frequency of adverse events (AEs)/serious adverse events (SAEs), throughout the study while on treatment with Namuscla, Incidence of adverse events of special interest (AESI), Mean change in Visual Analogue Scale (VAS) or Faces score for muscle stiffness (myotonia severity) for children and adolescents aged 6 years to < 18 years (assessed every 3 months)., Score of handgrip myotonia as quantitatively measured using a commercially available grip dynamometer and computerized capture system in standardized conditions for children and adolescents aged 6 years to < 18 years (every 6 months).
Endpoint(s): Mean change in VAS (8 to < 18 years) or Faces (6 to < 8 years) score for severity of muscle stiffness (if not a primary endpoint) pain, weakness and fatigue (every 3 months)., Clinical myotonia assessment (every 6 months) - Mean change in time to open the eyes after forced eye closure as measured on a stopwatch (when eyelid myotonia present), Clinical myotonia assessment (every 6 months) - Clinical improvement in flexor myotonia (right hand flexor muscles), Clinical myotonia assessment (every 6 months) - Mean change in time to perform Timed-up and go (TUG) test (patients aged 6 to <18 years only), Mean change in health-related quality-of-life as measured by the Paediatric Quality of Life (PedsQL) score (secondary endpoint for patients aged 6 years to <18 years; every 6 months)., Clinical Global Impression (CGI) scores (efficacy and tolerability) evaluated by the patient, a parent or proxy and by the investigator. Measured every 6 months., Mean change in Myotonia Behaviour Scale (MBS) scores (for patients aged 6 years to < 18 years; measured every 6 months)., Long-term safety of mexiletine - Changes in vital signs (every 3 months)., Long-term safety of mexiletine - Changes in clinical laboratory values (every 3 months).

Source: https://euclinicaltrials.eu/ctis-public/view/2024-513484-89-00